EU clinical trial 2024-516493-30-01: The sedative effects and local tolerability of nasal administration of remimazolam using a Soft Mist Nasal Administration Device
Sponsor: Stichting Radboud universitair medisch centrum (Hospital/Clinic/Other health care facility). Phase: Therapeutic exploratory (Phase II). Countries: Netherlands (ended).
Therapeutic area(s): Analytical, Diagnostic and Therapeutic Techniques and Equipment [E] - Anesthesia and Analgesia [E03]
Gender: Female, Male. Age: 18-64 years. Enrolment: 20.
Status: Ended. Start date (EU): 2025-03-10. End date (EU): 2025-04-13. Decision date: 2025-01-22. Results received: No. Last updated: 2025-01-22.

Condition(s): stress anxiety, anxiety
Product: Byfavo 20 mg powder for solution for injection

Primary endpoint: • Maximum decrease in Bispectral Index (BIS) value compared with baseline BIS.
Endpoint(s): • Changes in BIS signal over time., • Richmond Agitation Sedation Scale (RASS) score at baseline and T = 5, 10, 15, 20, 30, 40, 50, 60, 90, 180 min. • Self-reported bipolar measure of alertness/drowsiness on a 0-100 VAS-scale at baseline and T = 5, 10, 15, 20, 30, 40, 50, 60, 90, 180 min. • Self-reported bipolar measure of agitation/relaxation on a 0-100 VAS scale at baseline and T = 5, 10, 15, 20, 30, 40, 50, 60, 90, 180 min. • Self-reported unipolar measure of perceived drug effects on a 0-100 VAS scale at baseline and T = 5, 10, • Self-reported bipolar measure of alertness/drowsiness on a 0-100 VAS-scale at baseline and T = 5, 10, 15, 20, 30, 40, 50, 60, 90, 180 min., • Self-reported bipolar measure of agitation/relaxation on a 0-100 VAS scale at baseline and T = 5, 10, 15, 20, 30, 40, 50, 60, 90, 180 min., • Self-reported unipolar measure of perceived drug effects on a 0-100 VAS scale at baseline and T = 5, 10, 15, 20, 30, 40, 50, 60, 90, 180 min.

Source: https://euclinicaltrials.eu/ctis-public/view/2024-516493-30-01